EU clinical trial 2024-516096-32-00: Randomized Phase II study comparing neo-epitope based vaccine OSE2101 (TEDOPI®) with or without anti-PD1 (Pembrolizumab) versus best supportive care as maintenance treatment in platinum-sensitive recurrent ovarian cancer patient with controlled disease after Platinum-based chemotherapy (TEDOVA Study)
Protocol code: GINECO-OV244b
Sponsor: Asso De Recherche Cancers Gynecologiques (Laboratory/Research/Testing facility). Phase: Therapeutic exploratory (Phase II). Countries: France (ongoing, recruitment ended), Germany (ongoing, recruitment ended), Belgium (ongoing, recruitment ended).
Therapeutic area(s): Diseases [C] - Neoplasms [C04]
Gender: Female. Age: 18-64 years, 65+ years. Enrolment: 180.
Status: Ongoing, recruitment ended. Start date (EU): 2021-08-05. Decision date: 2024-10-14. Results received: No. Last updated: 2026-01-23.
Decision dates by country: BE: 2024-10-14, FR: 2024-10-16, DE: 2024-11-14

Condition(s): Platinum sensitive recurrent ovarian cancer
Product: KEYTRUDA 25 mg/mL concentrate for solution for infusion, TEDOPI

Primary endpoint: Progression Free Survival (PFS) is the time from randomization to progression, assessed radiologically using RECIST 1.1 by the investigator, or death whatever the cause, whichever comes first. Patients alive and free of progression at the cut-off date will be censored at the last tumor assessment date.
Endpoint(s): Objective response is defined using the RECIST 1.1. The best overall response is defined as the best radiological response observed over the whole treatment period before progression or subsequent anti-cancer treatment. Proportion of parti, Safety will be assessed based on NCI CTC-AE version 5.0, Time to subsequent first treatment (TTST-1) is defined as time from randomization to initiation of first subsequent treatment (including treatment change due to toxicity or investigator's decision). Deaths will be counted as events. Patients alive and not receiving a subsequent treatment will be censored at the last assessment date., Time to subsequent second treatment (TTST-2) is defined as time from randomization to initiation of second subsequent treatment (including treatment change due to toxicity or investigator's decision). Deaths will be counted as events. Patients alive and not receiving a subsequent treatment will be censored at the last assessment date., Overall survival is defined as time from randomization to the date of death, whatever the cause. Patients alive at the cut-off date will be censored at the last date they are known to be alive.

Source: https://euclinicaltrials.eu/ctis-public/view/2024-516096-32-00